EU clinical trial 2023-505322-34-00: A Phase 1a/1b Study Investigating the Safety, Tolerability, Pharmacokinetics, Pharmacodynamics, and Preliminary Antitumor Activity of BGB-A3055, Alone and in Combination With Tislelizumab in Patients With Selected Advanced or Metastatic Solid Tumors
Protocol code: BGB-A317-A3055-101
Sponsor: Beigene Ltd. (Pharmaceutical company). Phase: Human Pharmacology (Phase I)- First administration to humans. Countries: France (ended).
Therapeutic area(s): Diseases [C] - Neoplasms [C04]
Gender: Female, Male. Age: 18-64 years, 65+ years. Enrolment: 45.
Status: Ended. Start date (EU): 2024-01-08. End date (EU): 2026-01-27. End date: 2026-02-09. Decision date: 2023-12-04. Results received: No. Last updated: 2025-11-18.

Condition(s): Advanced or metastatic solid tumors

Source: https://euclinicaltrials.eu/ctis-public/view/2023-505322-34-00